EU clinical trial 2023-505992-54-00: A Phase 1b, Multicenter, 2-Part, Open-Label Study of Datopotamab Deruxtecan (Dato-DXd) in Combination with Immunotherapy with or without Carboplatin in Participants with Advanced or Metastatic Non‑Small Cell Lung Cancer (Tropion-Lung04)
Protocol code: D926FC00001
Sponsor: Astrazeneca AB (Pharmaceutical company). Phase: Human Pharmacology (Phase I)- Other. Countries: Belgium (ongoing, recruitment ended), Poland (ongoing, recruitment ended), Spain (ongoing, recruitment ended), Italy (ended).
Therapeutic area(s): Diseases [C] - Neoplasms [C04]
Gender: Female, Male. Age: 18-64 years, 65+ years. Enrolment: 75.
Start date (EU): 2022-10-21. Decision date: 2024-06-25. Results received: No. Last updated: 2026-03-27.
Decision dates by country: ES: 2024-06-27, PL: 2024-07-05, IT: 2024-07-01, BE: 2024-06-25

Condition(s): Advanced or Metastatic Non-small Cell Lung Cancer (NSCLC)
Product: MYCOPHENOLATE MOFETIL, INFLIXIMAB, Rilvegostomig, Rilvegostomig, volrustomig, CARBOPLATIN, IMFINZI 50 mg/mL concentrate for solution for infusion., Datopotamab deruxtecan, AZD7789

Primary endpoint: Safety and tolerability of combination treatment with Dato-DXd and immunotherapy with or without up to 4 cycles of carboplatin, as measured by DLTs, TEAEs, SAEs, AESIs, ECOG PS, vital sign measurements, standard clinical laboratory parameters (hematology, clinical chemistry, and urinalysis), ECG parameters, ECHO/MUGA scan findings, and ophthalmologic findings
Endpoint(s): Efficacy of combination treatment with Dato-DXd and immunotherapy, with or without up to 4 cycles of carboplatin as measured by ORR, DoR, DCR, PFS, TTR, Best percentage change in the SoD of measurable tumors and OS, PK of Dato-DXd, durvalumab, AZD2936, MEDI5752 and AZD7789, with or without up to 4 cycles of carboplatin as assessed by plasma concentrations and PK parameters of Dato-Dxd, total anti-TROP2 antibody and DXd (MAAA-1181a). Serum concentrations and PK parameters of durvalumab, AZD2936, MEDI5752 and AZD7789, Immunogenicity of Dato-DXd, durvalumab, AZD2936, MEDI5752 and AZD7789 with or without 4 cycles of carboplatin as assessed by the prevalence and incidence of Dato-DXd, durvalumab, AZD2936, MEDI5752 and AZD7789 ADA.

Source: https://euclinicaltrials.eu/ctis-public/view/2023-505992-54-00